EU clinical trial 2024-518092-62-00: Conservative vs conventional oxygen administration in critically ill patients: effects on ICU mortality. A multicentre randomized open label clinical trial.
Protocol code: ICUConservativeO2
Sponsor: Azienda Ospedaliero Universitaria Di Modena (Hospital/Clinic/Other health care facility). Phase: Therapeutic confirmatory (Phase III). Countries: Italy (ongoing, recruiting).
Therapeutic area(s): Diseases [C] - Bacterial Infections and Mycoses [C01]
Gender: Female, Male. Age: 18-64 years, 65+ years. Enrolment: 1000.
Status: Ongoing, recruiting. Start date (EU): 2024-12-09. Decision date: 2024-12-09. Results received: No. Last updated: 2026-01-20.

Condition(s): Adult critically ill patients requiring non-invasive (NIMV) or invasive mechanical ventilation (IMV)
Product: OXYGEN

Primary endpoint: ICU mortality rate, defined as the number of deaths for any cause occurred strictly during the ICU stay (censored at day 90).
Endpoint(s): - 90-day mortality, - The occurrence of new organ dysfunction defined as a SOFA score ≥3 for the corresponding organ, occurring ≥48 hours after ICU admission, - bloodstream, respiratory and surgical site infections, - VFHs during the ICU stay, - VasoFHs during the ICU stay, - ICU free days at 28-day and at 90-day, - Cognitive Dysfunction at ICU discharge (censored at 90 days) by MMSE, - ICU acquired weakness at ICU discharge (censored at 90 days) by MRC Scale.

Source: https://euclinicaltrials.eu/ctis-public/view/2024-518092-62-00